EU clinical trial 2025-522918-23-00: BBT001 in Healthy Volunteers and in Adult Patients with Atopic Dermatitis
Protocol code: BBT001-001
Sponsor: Bambusa Therapeutics Inc. (Pharmaceutical company). Phase: Human Pharmacology (Phase I)- First administration to humans. Countries: Poland (authorised, recruitment pending).
Therapeutic area(s): Diseases [C] - Skin and Connective Tissue Diseases [C17]
Gender: Female, Male. Age: 18-64 years, 65+ years. Enrolment: 10.
Status: Authorised, recruitment pending. Decision date: 2025-11-21. Results received: No. Last updated: 2026-06-25.

Condition(s): Atopic Dermatitis

Source: https://euclinicaltrials.eu/ctis-public/view/2025-522918-23-00